EU clinical trial 2023-504792-24-00: A research study to look at how CagriSema influences food intake, appetite and emptying of the stomach in people with excess body weight
Protocol code: NN9838-4695
Sponsor: Novo Nordisk A/S (Pharmaceutical company). Phase: Human Pharmacology (Phase I)- Other. Countries: Germany (ended).
Therapeutic area(s): Diseases [C] - Nutritional and Metabolic Diseases [C18]
Gender: Female, Male. Age: 18-64 years, 65+ years. Enrolment: 60.
Status: Ended. Start date (EU): 2024-02-20. End date (EU): 2024-11-22. Decision date: 2024-01-09. Results received: No. Last updated: 2025-08-22.

Condition(s): Obesity

Source: https://euclinicaltrials.eu/ctis-public/view/2023-504792-24-00